EU clinical trial 2024-519594-19-00: Neoadjuvant pembrolizumab in patients with stage IIb/c melanoma, a phase II double-blind placebo-controlled randomized trial NEOPRIME
Protocol code: NEOPRIME
Sponsor: Vaestra Goetalandsregionen (Hospital/Clinic/Other health care facility). Phase: Therapeutic exploratory (Phase II). Countries: Sweden (authorised, recruitment pending).
Therapeutic area(s): Diseases [C] - Neoplasms [C04]
Gender: Female, Male. Age: 18-64 years, 65+ years. Enrolment: 30.
Status: Authorised, recruitment pending. Decision date: 2025-06-19. Results received: No. Last updated: 2025-06-19.

Condition(s): Stage IIb/c melanoma
Product: Natriumklorid Fresenius Kabi 9 mg/ml infusionsvätska, lösning, KEYTRUDA 25 mg/mL concentrate for solution for infusion

Primary endpoint: Pathological response rate
Endpoint(s): Frequency and severity of adverse events (AEs) and serious adverse events (SAEs), Feasibility of neoadjuvant therapy in stage II melanoma, Sentinel lymph node positivity rate, Local recurrence rate, Regional recurrence rate, Recurrence-free survival (RFS), Distant-metastasis free survival, Melanoma-specific survival (MSS), Overall survival (OS), Change in dermoscopic features and correlation to histopathology, Change in tumor thickness as assessed with ultrasound and correlation to histopathology, Change in ctDNA levels during and after neoadjuvant treatment and surgery, Change in T-cell receptor repertoire before and after neoadjuvant treatment, Predictive and prognostic biomarker discovery

Source: https://euclinicaltrials.eu/ctis-public/view/2024-519594-19-00